EU clinical trial 2025-521567-12-00: Efficacy and safety assessment of T1695 ophthalmic suspension, versus Ciclosporin ophthalmic emulsion, in participants with moderate to severe Vernal Keratoconjunctivitis (VKC)
Protocol code: LT1695-201
Sponsor: Laboratoires Thea (Pharmaceutical company). Phase: Therapeutic exploratory (Phase II). Countries: Spain (authorised, recruitment pending), Italy (authorised, recruitment pending), Bulgaria (authorised, recruitment pending), France (authorised, recruitment pending), Greece (authorised, recruitment pending).
Therapeutic area(s): Diseases [C] - Eye Diseases [C11]
Gender: Female, Male. Age: 0-17 years. Enrolment: 72.
Status: Authorised, recruitment pending. Decision date: 2025-11-04. Results received: No. Last updated: 2026-05-11.
Decision dates by country: BG: 2025-11-10, FR: 2025-11-10, GR: 2025-11-04, IT: 2025-11-07, ES: 2025-11-11

Condition(s): Vernal Keratoconjunctivitis (VKC)
Product: Verkazia 1 mg/mL eye drops, emulsion

Primary endpoint: Change from baseline (D1) at D29 (W4) in Corneal Fluorescein Staining (CFS) grade assessed by the (0-5) modified Oxford scale in the study eye.
Endpoint(s): 1. Change from baseline (D1) at D29 (W4) in the 0 to 100mmVisual Analog Scales (VAS) value among 4 symptoms associated with VKC: photophobia, tearing, itching and mucous discharge in the study eye and contralateral eye, 2. Change from baseline (D1) at D29 (W4) in CFS grade assessed by the (0-5) modified Oxford scale in the contralateral eye., 3. Change from baseline (D1) at each post-baseline visit in CFS grade assessed by the (0-5) modified Oxford scale the study eye and contralateral eye., 4. Change from baseline (D1) at each post-baseline assessment in the 0-100mm VAS value among 4 symptoms associated with VKC: photophobia, tearing, itching and mucous discharge in the study eye and contralateral eye., 5. Change from baseline (D1) at each post-baseline visit in the study eye and/or contralateral eye in: • VKC severity (Bonini scale 0–5) • Bulbar hyperaemia • Trantas dots • Tarsal papillae (all via slit lamp) • Corneal/limbal staining (VKC-CLEK scale)., 6. Presence of corneal ulcer at each post-baseline visit in the study eye and contralateral eye., 7. Change from baseline (D1) at each post-baseline visit in the Quality of Life (QoL) Questionnaire scores (QUICK questionnaire (score 16-48) and Impact on ability to attend school (score1-3))., 8. IMP Responder status (as defined in section Study design) (Y/N) at each post-baseline visit., 9. First post-baseline visit (day) with IMP response., 10. Efficacy assessed by the investigator at each post-baseline visit., 11. Change from baseline (D1) and from D85 at each visit in the study eye and contralateral eye in: • CFS (Oxford scale 0–5) • The 0–100 mm VAS for VKC among symptoms associate (photophobia, tearing, itching, discharge) • Clinical grading of VKC - severity (Bonini scale 0–5) • Bulbar conjunctiva hyperaemia, Limbus Trantas dot, or tarsal conjunctival papillae assessed by slit lamp examination., 12. Presence of corneal ulcer at each visit in the study eye and contralateral eye., 13. Use of rescue medication (Y/N) at each visit in the study eye and contralateral eye., 14. Presence of recurrence (Y/N) (as defined in section Study design) of active VKC at any time post-D85., 15. Time to recurrence (in days)., 16. Ocular and systemic treatment-emergent adverse event (TEAE) and related TEAE by System Organ Class (SOC) and Preferred Term (PT), TEAE leading to study treatment discontinuation, Serious TEAE., 17. Change from baseline (D1) and from D85 at each post-baseline visit separately for study eye and contralateral eye in: • The Far Best Corrected Visual Acuity expressed in LogMAR. • Each ocular sign scores.", 18. Ocular tolerance of the eye drop assessed by the investigator at each post-baseline visit., 19. Ocular tolerance of the eye drop assessed by the participant (or relatives) at each post-baseline visit., 20. Change from baseline (D1) and from D85 in Intraocular Pressure (IOP) separately for study eye and contralateral eye at each post-baseline visit., 21. Change from baseline (D1) and from D85 in Vital signs at each post-baseline visit., 22. Blood concentration of tacrolimus (ng/mL) at the baseline visit (D1, before IMP instillation) and at D29 (between 1h and 3h post IMP instillation) (Period 1)., 23. Change from baseline (D1) in complete blood count (CBC), basic metabolic panels, kidney and liver tests at the baseline visit (D1, before IMP instillation) and at D85 (Period 1)., 24. AE and SAE (Serious Adverse Event) by SOC and PT.

Source: https://euclinicaltrials.eu/ctis-public/view/2025-521567-12-00